EU clinical trial 2023-503615-14-00: A Phase 2 Randomized Clinical Study of MK-4280A (coformulated favezelimab [MK-4280] plus pembrolizumab [MK-3475]) Versus Physician’s Choice Chemotherapy in PD-(L)1-refractory, Relapsed or Refractory Classical Hodgkin Lymphoma (KEYFORM-008)
Protocol code: MK-4280A-008
Sponsor: Merck Sharp & Dohme LLC (Pharmaceutical company). Phase: Therapeutic exploratory (Phase II). Countries: Germany (ended), Czechia (ended), Belgium (ended), Sweden (ended), France (ended), Spain (ended), Poland (ended).
Therapeutic area(s): Diseases [C] - Neoplasms [C04]
Gender: Female, Male. Age: 18-64 years, 65+ years. Enrolment: 54.
Status: Ended. Start date (EU): 2022-09-29. End date (EU): 2025-12-31. End date: 2026-01-08. Decision date: 2023-08-02. Results received: No. Last updated: 2026-01-27.
Decision dates by country: SE: 2023-08-02, BE: 2023-08-10, FR: 2023-08-02, DE: 2023-08-08, PL: 2023-09-13, ES: 2023-08-07, CZ: 2023-08-02

Condition(s): Relapsed or Refractory Classical Hodgkin Lymphoma
Product: GEMCITABINE, MK-4280A, BENDAMUSTINE

Primary endpoint: Progression-Free Survival (PFS) per Lugano Response Criteria as Assessed by Investigator
Endpoint(s): Overall Survival (OS), Objective Response Rate (ORR) per Lugano Response Criteria as Assessed by Investigator, Duration of Response (DOR) per Lugano Response Criteria as Assessed by Investigator, Number of Participants Who Experienced At Least One Adverse Event (AE), Number of Participants Who Discontinued Study Treatment Due to an Adverse Event (AE)

Source: https://euclinicaltrials.eu/ctis-public/view/2023-503615-14-00